EU clinical trial 2025-523284-37-00: CHARACTERIZATION OF ASTROCYTE REACTIVITY WITH [18F]F-DED PET IN NEURODEGENERATIVE DISEASES
Protocol code: Astrocyte-PET/BBRC
Sponsor: Barcelonabeta Brain Research Center (Laboratory/Research/Testing facility). Phase: Therapeutic exploratory (Phase II). Countries: Spain (ongoing, recruiting).
Therapeutic area(s): Diseases [C] - Nervous System Diseases [C10]
Gender: Female, Male. Age: 18-64 years, 65+ years. Enrolment: 300.
Status: Ongoing, recruiting. Start date (EU): 2026-06-11. Decision date: 2026-03-24. Results received: No. Last updated: 2026-04-15.

Condition(s): Dementia, Cerebral autosomal dominant arteriopathy with subcortical infarcts and leukoencephalopathy (CADASIL), Late onset Alzheimer Disease, Autosomal Dominant Alzheimer's Disease, Sporadic early onset Alzheimer Disease
Product: [18F]DED

Source: https://euclinicaltrials.eu/ctis-public/view/2025-523284-37-00